EU clinical trial 2024-513084-38-00: SALMA Study - Phase I/II Clinical Trial Assessing the Combination of Sulfasalazine with Standard of Care Induction Therapy in Newly Diagnosed Non-Favorable Acute Myeloid Leukemias (AML) Patients 60 years or older
Protocol code: APHP211176
Sponsor: Assistance Publique Hopitaux De Paris (Hospital/Clinic/Other health care facility). Phase: Phase I and Phase II (Integrated)- Other. Countries: France (ongoing, recruiting).
Therapeutic area(s): Diseases [C] - Hemic and Lymphatic Diseases [C15]
Gender: Female, Male. Age: 18-64 years, 65+ years. Enrolment: 64.
Status: Ongoing, recruiting. Start date (EU): 2025-04-15. Decision date: 2024-06-14. Results received: No. Last updated: 2025-05-16.

Condition(s): Recently diagnosed non favorable Acute Myeloid Leukemias
Product: CYTARABINE, SULFASALAZINE, IDARUBICIN HYDROCHLORIDE

Primary endpoint: Phase I : Documentation during the dose escalation of dose limiting toxicity (DLT), Phase I : Identification of a maximal tolerated dose (MTD) anticipated to be the recommended phase II dose (RP2D) - MTD is defined by a target DLT rate of 33%, assessed during the dose escalation phase by a continual reassessment method - RP2D is anticipated to be the MTD. However, it could be equal to one dose level lower than the MTD. It will be determined in interaction with the DSMB, insofar that this dose level is validated by PK/PD studies and efficacy preliminary data., Phase II : MRD-negative Complete Response at EOI (day 28-42) per ELN 2022 Criteria
Endpoint(s): Assessment of safety - Safety outcome measures will be assessed continuously during the study. Monitoring of ECGs and clinical laboratory values are integral to safety assessment. Adverse events (AE), treatment emergent adverse events (TEAE) and treatment-related TEAEs will be evaluated according to the NCI CTCAE version 5.0., Pharmacokinetics - To assess SSZ and its metabolites, IDA (and its metabolite) and AraC. This will allow to determine a PK model for SSZ at an early and late time point and confirm the lack of interaction between SSZ and IDA or AraC., Pharmacodynamics - Pharmacodynamic assays aim at demonstrating ROS induction upon SSZ exposure relative to pre-treatment levels., Antileukemia activity - Response at EOI assessment (day 28-42) per ELN 2022 Criteria., Antileukemia activity - Survival assessment at 12 months

Source: https://euclinicaltrials.eu/ctis-public/view/2024-513084-38-00